EU clinical trial 2022-500800-24-00: Phase 1/2 Study of Linvoseltamab (Anti-BCMA X Anti-CD3 Bispecific Antibody) in Previously Untreated Patients With Symptomatic Multiple Myeloma
Protocol code: R5458-ONC-2158
Sponsor: Regeneron Pharmaceuticals Inc. (Pharmaceutical company). Phase: Therapeutic exploratory (Phase II). Countries: Spain (ongoing, recruiting), France (ongoing, recruiting).
Therapeutic area(s): Diseases [C] - Neoplasms [C04]
Gender: Female, Male. Age: 18-64 years, 65+ years. Enrolment: 76.
Status: Ongoing, recruiting. Start date (EU): 2024-09-19. Decision date: 2023-09-25. Results received: No. Last updated: 2026-05-19.
Decision dates by country: ES: 2023-09-25, FR: 2023-09-25

Condition(s): Multiple Myeloma
Product: Linvoseltamab, Linvoseltamab, DEXAMETHASONE, DEXAMETHASONE

Primary endpoint: Phase 1: Incidence of dose-limiting toxicities (DLTs), Phase 1: Incidence of treatment-emergent adverse events (TEAEs), Phase 1: Severity of treatment-emergent adverse events (TEAEs), Phase 1: Incidence of adverse events of special interest (AESIs), Phase 1: Severity of adverse events of special interest (AESIs), Phase 2: Proportion of participants with a very good partial response (VGPR) or better using the International Myeloma Working Group (IMWG) response criteria, Phase 2 Transplant-eligible cohort: Proportion of participants achieving Minimal Residual Disease (MRD) negative status (at 10^-5) after induction with consolidation therapy, Phase 2 Transplant-eligible cohort: Proportion of participants achieving MRD-negative status (at 10^-5) after induction without consolidation therapy, Phase 2 Transplant-ineligible cohort: Proportion of participants achieving MRD-negative status as their best response after treatment period I with continuing to treatment period II, Phase 2 Transplant ineligible cohort: Proportion of participants achieving MRD-negative status as their best response after treatment period I without continuing to treatment period II
Endpoint(s): Phase 1 and 2: Concentrations of Linvoseltamab in serum, Phase 1 and 2: Concentrations of total soluble B-cell maturation antigen (BCMA), Phase 1 and 2: Incidence of anti-drug antibodies (ADAs) to Linvoseltamab, Phase 1 and 2: Magnitude of ADAs to Linvoseltamab, Phase 1: Objective response rate (ORR) measured using the IMWG criteria, Phase 1: Duration of Response (DOR) measured using the IMWG criteria, Phase 1: Progression-free survival (PFS) measured using the IMWG criteria, Phase 1: Proportion of participants achieving MRD-negative status (at 10^-5) in participants with NDMM measured using the IMWG criteria, Phase 2: Incidence of treatment-emergent adverse events (TEAEs), Phase 2: Severity of TEAEs, Phase 2: Incidence of adverse events of special interest (AESIs), Phase 2: Severity of AESIs, Phase 2: ORR of participants deemed transplant-eligible and transplant-ineligible by the treating physician, Phase 2: MRD-negative status of participants deemed transplant-eligible and transplant-ineligible by the treating physician, Phase 2: DOR of participants deemed transplant-eligible and transplant-ineligible by the treating physician, Phase 2: PFS of participants deemed transplant-eligible and transplant-ineligible by the treating physician, Phase 2: Overall Survival (OS) of participants deemed transplant-eligible and transplant-ineligible by the treating physician, Phase 2: Time to response (TTR) as measured using the IMWG criteria, Phase 2: ORR by risk levels, Phase 2: MRD-negative status by risk levels, Phase 2: DOR by risk levels, Phase 2: TTR by risk levels, Phase 2: PFS by risk levels, Phase 2: Incidence of MRD-negative status, Phase 2 Transplant-eligible cohort: Cluster of differentiation 34+ (CD34+) stem cell yield, Phase 2 Transplant-eligible cohort: Time to neutrophil engraftment, Phase 2 Transplant-eligible cohort: Time to platelet engraftment, Phase 2 Transplant-eligible cohort: PFS after ASCT followed by 3 cycles of linvoseltamab

Source: https://euclinicaltrials.eu/ctis-public/view/2022-500800-24-00